EU clinical trial 2024-512595-35-00: RETRAIN - Multicentre randomised double-blind superiority trial with a roll-over phase to evaluate the efficacy of OM-89 vs placebo in reducing antibiotic consumption associated with the treatment of urinary tract infections in patients with a neurological bladder.
Protocol code: RETRAIN
Sponsor: Centre Hospitalier Universitaire De Dijon (Hospital/Clinic/Other health care facility). Phase: Therapeutic confirmatory (Phase III). Countries: France (ongoing, recruiting).
Therapeutic area(s): Diseases [C] - Bacterial Infections and Mycoses [C01]
Gender: Female, Male. Age: 18-64 years, 65+ years. Enrolment: 110.
Status: Ongoing, recruiting. Start date (EU): 2024-11-21. Decision date: 2024-08-19. Results received: No. Last updated: 2026-03-12.

Condition(s): neurogenic bladder, Recurrent urinary tract infections
Product: URO-VAXOM CAPSULES PLACEBO, Uro-Vaxom 6 mg cápsula

Primary endpoint: Number of antibiotic treatment episodes for UTIsper person-days at risk during the first year. An episode of treatment is defined as a single prescription of a given antibiotic, regardless of its intended duration (curative or prophylactic). A day at risk is defined as a follow-up day without antibiotic treatment
Endpoint(s): Number of symptomatic urinary tract infections - febrile and non-febrile - at M12 and M24 (compared with M12), Number of febrile urinary tract infections at M12 and M24 (compared with M12), Number of hospitalisations for urinary tract infections at M12 and M24 (compared with M12), Number of hospital admissions for sepsis with a urinary tract origin at M12 and M24 (compared with M12), Number of days spent on antibiotics at M12 and M24 (compared with M12) : for urinary indications / for any indication, Number of days spent on antibiotics with a significant ecological impact at M12 and M24 (compared with M12), Number of courses of antibiotics for urinary indications at M12 and M24 (compared to M12), Number of courses of antibiotics, whatever the indication, at M12 and M24 (compared with M12)., Quality of life score assessed at M0, M6 and M12, M18 and M24, using the Qualiveen questionnaire., Number of adverse events (AEs) and relationship to OM-89 : Grade 1 mild AE - Grade 2 Moderate AE - Grade 3 Severe AE - Grade 4 Life-threatening or disabling AEs - Grade 5 AE-related death

Source: https://euclinicaltrials.eu/ctis-public/view/2024-512595-35-00